EU clinical trial 2024-516267-83-00: Phase 2a, single center, randomized, double-blind, study to evaluate the immunogenicity and safety of one single administration of OVX836 influenza vaccine at two dose levels (180µg or 480μg) given intramuscularly (IM), either as a booster or a primary vaccination in healthy adults previously administered with OVX836, Influvac Tetra® or placebo in the OVX836-002 (EudraCT number: 2019-002939-28) and OVX836-003 (EudraCT number: 2021-002535-39) studies
Protocol code: OVX836-007
Sponsor: OSIVAX Belgique (Pharmaceutical company). Phase: Therapeutic exploratory (Phase II). Countries: Belgium (ended).
Therapeutic area(s): Diseases [C] - Virus Diseases [C02]
Gender: Female, Male. Age: 18-64 years. Enrolment: 117.
Status: Ended. Start date (EU): 2024-10-15. End date (EU): 2025-06-02. Decision date: 2024-10-04. Results received: Yes. Last updated: 2025-04-02.

Condition(s): Influenza

Primary endpoint: Safety evaluation of OVX836 (180µg and 480µg): Number and percentage of subjects reporting solicited local and systemic symptoms within 7 days after vaccine administration., Safety evaluation of OVX836 (180µg and 480µg): Number and percentage of subjects reporting unsolicited AEs within 29 days after vaccine administration., Safety evaluation of OVX836 (180µg and 480µg): Number and percentage of subjects reporting SAEs during the entire study duration., Number and percentage of subjects reporting ILIs and RT-PCR confirmed influenza A or B (overall and occurring more than 14 days post-vaccination, i.e., vaccine failure), RSV, SARS-CoV-2 and/or other respiratory infectious agents.
Endpoint(s): Cell-mediated immune response to OVX836 (180µg and 480µg) in terms of NP-specific IFNγ spot forming cells frequencies in peripheral blood, measured by ELISPOT, at Days 8 and 29 versus pre-injection baseline (Day 1)., Frequencies of NP-specific CD4+ and CD8+T-cells expressing IL-2, TNFα and/or IFNγ, measured by flow cytometry, following in vitro stimulation of PBMC collected on Days 8 and 29 as compared to frequencies observed in PBMC collected at baseline, i.e. pre-injection on Day 1., Cross-reactivity of the NP influenza-specific responses by IFNγ ELISPOT against selected circulating and emerging strains of influenza., Geometric mean titers (GMTs) of anti-NP Immunoglobulin G (IgG) (ELISA, serum) at Days 8 and 29 versus pre-injection baseline (Day 1)., Number and percentage of subjects with an increase (two-fold and four-fold) in anti-NP IgG (ELISA, serum) titer at Days 8 and 29 versus pre-injection baseline (Day 1)., GMTs of anti-OVX313 tag (Oligodom®) IgG level (ELISA, serum) at Days 8 and 29 versus pre-injection baseline (Day 1)., Anti-C4bp (C4b-binding protein) oligomerization domain IgG titers (ELISA, serum) at Days 8 and 29 versus pre-injection baseline (Day 1), in subjects with positive result for anti-OVX313 (anti-OVX313 titer >12.5).

Source: https://euclinicaltrials.eu/ctis-public/view/2024-516267-83-00